EU clinical trial 2024-513188-17-03: Simvastatin in the Prevention of Recurrent Pancreatitis, a Triple Blind, Randomized Controlled Trial.
Protocol code: SIMBA-16
Sponsor: Hospital General Universitario Dr. Balmis (Hospital/Clinic/Other health care facility). Phase: Therapeutic use (Phase IV). Countries: Spain (ended).
Therapeutic area(s): Diseases [C] - Digestive System Diseases [C06]
Gender: Female, Male. Age: 18-64 years, 65+ years. Enrolment: 144.
Status: Ended. End date (EU): 2025-01-01. Decision date: 2024-09-25. Results received: Yes. Last updated: 2024-09-25.

Condition(s): Recurrent pancreatitis
Product: SIMVASTATIN, LACTOSE MONOHYDRATE

Primary endpoint: Recurrence of Pancreatitis (dichotomous)
Endpoint(s): Recurrences (dichotomous variable), recurrence (Kaplan-Meier analysis), new-onset diabetes, new-onset exocrine pancreatic insufficiency, severity of recurrent Pancreatitis, number of days admitted due to recurrent AP. Number of visits to the emergency room and admissions due to abdominal pain without meeting criteria for acute pancreatitis. Imaging signs of Chronic Pancreatitis.

Source: https://euclinicaltrials.eu/ctis-public/view/2024-513188-17-03